EU clinical trial 2024-513155-32-00: Tildrakizumab, an Anti-IL-23 Antibody for the Treatment of Refractory Chronic Spontaneous Urticaria – a single-arm, open-label, phase II study (TAILOR-CSU)
Protocol code: KKS-317
Sponsor: Philipps-Universitaet Marburg (Educational Institution). Phase: Therapeutic exploratory (Phase II). Countries: Germany (authorised, recruiting).
Therapeutic area(s): Diseases [C] - Skin and Connective Tissue Diseases [C17]
Gender: Female, Male. Age: 18-64 years, 65+ years. Enrolment: 18.
Status: Authorised, recruiting. Start date (EU): 2026-03-02. Decision date: 2025-09-15. Results received: No. Last updated: 2026-05-12.

Condition(s): chronic spontaneous urticaria
Product: Ilumetri 200 mg solution for injection in pre-filled syringe

Primary endpoint: Difference in the UAS7 score from baseline to week 20.
Endpoint(s): Difference of VAS pruritus score between baseline and week 20., Difference in the UCT score between baseline and week 20., Difference in the VAS disease activity score from baseline to week 20., Proportion of patients achieving a ≥50% reduction in UAS7 score from baseline to week 20., Proportion of patients achieving a UAS7 score < 6 at week 20., Proportion of patients achieving a UCT7 score > 12 at week 20., Difference in the overall CU-Q2oL score from baseline to week 20., Difference in variables from baseline to weeks 4, 8, 12, 16, 20, 24, and 28 during and after tildrakizumab treatment., Frequency and severity of adverse and serious adverse events., Proportion of patients achieving a complete response (UAS7 = 0) at the specified timepoint, Percentage of angioedema-free days (measured by AAS) in patients with angioedema specified follow-up period., Duration from the first occurrence of a ≥50% reduction from baseline UAS7 to the point at which the patient experiences a ≥50% increase from the nadir UAS7 achieved after treatment initiation., Proportion of patients achieving at least a 50% reduction compared to baseline in UAS7 at week 28., Immunological data: blood test at week 0, 4, 8, 16, 20, 28, (ELISPOT IL-17, IL-5, IFN-y, IL-10; flow cytometry: IL-23 and skin homing panel), histology at weeks 0, 20 (flow cytometry: skin panel incl. IL-4, IL-17, IFN-y)

Source: https://euclinicaltrials.eu/ctis-public/view/2024-513155-32-00